EU clinical trial 2024-510965-41-00: A Phase 3, Multicenter, Randomized, Open-Label Study of Epcoritamab Plus Lenalidomide Compared to Rituximab Plus Gemcitabine and Oxaliplatin in Participants with Relapsed or Refractory Diffuse Large B-Cell Lymphoma
Protocol code: M22-128
Sponsor: AbbVie Deutschland GmbH & Co. KG (Pharmaceutical company). Phase: Therapeutic confirmatory (Phase III). Countries: Portugal (ongoing, recruitment ended), Hungary (ongoing, recruitment ended), Bulgaria (ongoing, recruitment ended), Poland (ongoing, recruitment ended), Czechia (ongoing, recruitment ended), Croatia (ongoing, recruitment ended), Netherlands (ongoing, recruitment ended), Romania (ongoing, recruitment ended), Belgium (ongoing, recruitment ended), Greece (ongoing, recruitment ended), France (ongoing, recruitment ended).
Therapeutic area(s): Diseases [C] - Neoplasms [C04]
Gender: Female, Male. Age: 18-64 years, 65+ years. Enrolment: 116.
Status: Ongoing, recruitment ended. Start date (EU): 2024-09-03. Decision date: 2024-08-19. Results received: No. Last updated: 2026-06-02.
Decision dates by country: NL: 2024-08-22, GR: 2024-08-22, HU: 2024-08-26, BE: 2024-08-19, RO: 2024-08-26, FR: 2024-08-23, BG: 2024-08-26, HR: 2024-08-20, PT: 2024-08-21, CZ: 2024-08-20, PL: 2024-08-26

Condition(s): Relapsed or Refractory (R/R) Diffuse Large B-Cell Lymphoma (DLBCL)
Product: Gemcitabine 38 mg/ml Concentrate for Solution for Infusion, Oxaliplatin 5mg/ml Concentrate for Solution for Infusion, Revlimid 20 mg hard capsules, Truxima 500 mg concentrate for solution for infusion, Revlimid 25 mg hard capsules, Epcoritamab (GEN3013), Gemcitabine 38 mg/ml Concentrate for Solution for Infusion, Revlimid 5 mg hard capsules, Truxima 100 mg concentrate for solution for infusion, Epcoritamab (GEN3013)

Primary endpoint: Progression-free survival (PFS)
Endpoint(s): Percentage of Participants Who Achieve Complete response (CR), Overall Survival (OS), Percentage of Participants Who Achieve Minimal Residual Disease (MRD) Negativity Rate

Source: https://euclinicaltrials.eu/ctis-public/view/2024-510965-41-00